EU clinical trial 2023-508377-82-00: Lunsayil LTE: An extension trial assessing long-term spesolimab treatment in patients with Hidradenitis Suppurativa (HS)
Protocol code: 1368-0130
Sponsor: Boehringer Ingelheim International GmbH, Boehringer Ingelheim Espana S.A. (Pharmaceutical company). Phase: Phase II and Phase III (Integrated). Countries: Spain (ended), Slovakia (ended), France (ended), Finland (ended), Bulgaria (ended), Poland (ended), Belgium (ended), Czechia (ended), Greece (ended), Denmark (ended), Italy (ended), Lithuania (ended), Germany (ended), Austria (ended).
Therapeutic area(s): Diseases [C] - Skin and Connective Tissue Diseases [C17]
Gender: Female, Male. Age: 18-64 years, 65+ years. Enrolment: 99.
Status: Ended. Start date (EU): 2024-06-27. End date (EU): 2025-03-31. End date: 2025-04-11. Decision date: 2024-06-03. Results received: Yes. Last updated: 2025-02-11.
Decision dates by country: FI: 2024-06-03, ES: 2024-06-03, AT: 2024-06-04, DE: 2024-06-04, PL: 2024-06-10, DK: 2024-06-04, SK: 2024-06-03, FR: 2024-06-04, BE: 2024-06-03, IT: 2024-06-03, CZ: 2024-06-05, LT: 2024-06-05, GR: 2024-06-10, BG: 2024-06-10

Condition(s): Hidradenitis Suppurativa (HS)
Product: Spesolimab, Placebo matching to Spesolimab

Primary endpoint: Occurrence of treatment emergent adverse events (TEAE)

Source: https://euclinicaltrials.eu/ctis-public/view/2023-508377-82-00